EU clinical trial 2023-509007-33-00: A phase 2a, multicentre trial to evaluate the efficacy, safety and pharmacokinetics of RBD1016 in participants with chronic hepatitis D virus infection, including a randomized, single-blinded, placebo-controlled exploratory part
Protocol code: RC04T001
Sponsor: Ribocure Pharmaceuticals AB (Pharmaceutical company). Phase: Therapeutic exploratory (Phase II). Countries: Sweden (ongoing, recruitment ended).
Therapeutic area(s): Diseases [C] - Virus Diseases [C02]
Gender: Female, Male. Age: 18-64 years, 65+ years. Enrolment: 15.
Status: Ongoing, recruitment ended. Start date (EU): 2024-08-21. Decision date: 2024-03-14. Results received: No. Last updated: 2025-12-19.

Condition(s): Chronic hepatitis D virus infection
Product: The corresponding placebo solution consists of the 25 nM phosphate buffer solution with 4 μg of vitamin B2 added for colouring purposes only., RBD1016, Vemlidy 25 mg film-coated tablets.

Primary endpoint: Mean reduction (log10 value) vs. baseline in HDV RNA levels at end of trial (Week 60).
Endpoint(s): Frequency, intensity and seriousness of reported AEs, SAEs and AEs of special interest (AESIs) during the trial., Clinically significant changes in vital signs (systolic/diastolic blood pressure, pulse rate) and 12-lead safety ECG measurements, clinical laboratory parameters and physical examination findings., Proportion of participants with undetectable HDV RNA (i.e., < the limit of detection) or ≥ 2 log10 decrease in HDV RNA at end of trial (Week 60)., Proportion of participants with undetectable HDV RNA (i.e., < the limit of detection), or ≥ 2 log10 decrease in HDV RNA and alanine transaminase (ALT) normalisation, at end of trial (Week 60)., Mean maximum reduction (log10 value) in HDV RNA levels vs. baseline, at any timepoint during the trial., For participants with HBsAg levels > 100 IU/mL at baseline: Proportion of participants with HBsAg levels ≤ 10 IU/mL at end of trial (Week 60)., Mean reduction (log10 value) in HBsAg levels vs. baseline, at end of trial (Week 60)., Mean maximum reduction (log10 value) in HBsAg levels vs. baseline, at any timepoint during the trial., Plasma concentrations of RBD1016 (and metabolites, as applicable) and estimation of plasma PK parameters, including but not limited to AUC0-t, AUC0-inf and Cmax and/or standard model population PK parameters., Proportion of participants with positive immunogenicity, measured as anti-drug antibodies (ADAs) positive, at each evaluation time point up to end of trial (Week 60).

Source: https://euclinicaltrials.eu/ctis-public/view/2023-509007-33-00